EU clinical trial 2023-509350-63-00: An Open-label, Phase 1b/2 Study of Acalabrutinib Alone or in Combination Therapy in Subjects with B-cell Non-Hodgkin Lymphoma
Protocol code: ACE-LY-003
Sponsor: Acerta Pharma B.V. (Pharmaceutical company). Phase: Phase I and Phase II (Integrated)- Other. Countries: Italy (ongoing, recruitment ended).
Therapeutic area(s): Diseases [C] - Neoplasms [C04]
Gender: Female, Male. Age: 18-64 years, 65+ years. Enrolment: 2.
Status: Ongoing, recruitment ended. Start date (EU): 2020-09-16. Decision date: 2024-10-28. Results received: No. Last updated: 2026-07-30.

Condition(s): Relapsed/Refractory marginal zone lymphoma
Product: Calquence 100 mg hard capsules, Calquence 100 mg film-coated tablets

Primary endpoint: Efficacy: Investigator-assessed ORR according to the Lugano classification for NHL.
Endpoint(s): Monitoring and recording AEs and SAEs; hematology, serum chemistry, serum Ig, and T/B/NK-cell count results; vital signs measurements; ECOG; and concomitant medications., Investigator-assessed DOR, PFS, and OS according to the Lugano classification for NHL

Source: https://euclinicaltrials.eu/ctis-public/view/2023-509350-63-00